EU clinical trial 2024-517445-13-00: A Phase II, open label, single arm, multicentre study on THOracic Radiotherapy in Extensive Stage SCLC patients submitted to first line CHT-RT plus Durvalumab (MEDI4736)
Sponsor: Azienda Ospedaliero Universitaria Di Modena (Hospital/Clinic/Other health care facility). Phase: Therapeutic exploratory (Phase II). Countries: Italy (ended).
Therapeutic area(s): Diseases [C] - Neoplasms [C04]
Gender: Female, Male. Age: 18-64 years, 65+ years. Enrolment: 94.
Status: Ended. End date (EU): 2025-01-27. Decision date: 2024-11-11. Results received: No. Last updated: 2024-11-11.

Condition(s): Extended stage small cell lung cancer patients confirmed histologically in full, partial or stable response after platinum-etoposide chemo-immunotherapy candidate to maintenance immunotherapy with Durvalumab.
Product: DURVALUMAB

Primary endpoint: The assessment of 12-Months progression-free survival (PFS, defined as time from enrollment to the date of objective disease progression both locoregionally and/or systemically) or death for any cause in absence of progression of disease) in extensive stage SCLC patients
Endpoint(s): Overall survival, Loco-regional control, Metastasis-free survival, Overall response rate, Acute toxicity, Late toxicity, General security profile, Quality of life

Source: https://euclinicaltrials.eu/ctis-public/view/2024-517445-13-00